EU clinical trial 2023-506231-15-00: An Open-Label Extension Study to Assess the Long-term Effect of EDG-5506 on Safety, Biomarkers, and Functional Measures in Adults and Adolescents with Becker Muscular Dystrophy
Protocol code: EDG-5506-203
Sponsor: Edgewise Therapeutics Inc. (Pharmaceutical company). Phase: Therapeutic exploratory (Phase II). Countries: Denmark (ongoing, recruiting), Netherlands (ongoing, recruiting), Spain (ongoing, recruiting), Italy (ongoing, recruiting), France (ongoing, recruiting), Belgium (ongoing, recruiting), Germany (authorised, recruiting).
Therapeutic area(s): Diseases [C] - Musculoskeletal Diseases [C05]; Diseases [C] - Congenital, Hereditary, and Neonatal Diseases and Abnormalities [C16]
Gender: Male. Age: 18-64 years, 65+ years. Enrolment: 82.
Start date (EU): 2024-02-22. Decision date: 2023-12-11. Results received: No. Last updated: 2026-03-10.
Decision dates by country: FR: 2025-10-10, DK: 2023-12-11, IT: 2025-08-25, ES: 2025-09-15, BE: 2025-09-23, NL: 2023-12-11, DE: 2025-09-29

Condition(s): Becker Muscular Dystrophy
Product: EDG-5506, EDG-5506

Primary endpoint: 1. Incidence, frequency, and severity of TEAEs and SAEs
Endpoint(s): 1. Incidence laboratory test-related TEAEs, 2. Change from Baseline in: − Safety labs − Vital Signs − ECG parameters − Cardiac function as assessed by an echocardiogram − Pulmonary function as assessed by FEV1, FVC

Source: https://euclinicaltrials.eu/ctis-public/view/2023-506231-15-00